EU clinical trial 2024-511066-36-00: A Phase 3, Randomized, Multicenter, Double-Blind, Placebo-Controlled, Efficacy and Safety Study of Birtamimab Plus Standard of Care vs. Placebo Plus Standard of Care in Mayo Stage IV Subjects with Light Chain (AL) Amyloidosis
Protocol code: NEOD001-301
Sponsor: Prothena Biosciences Limited (Pharmaceutical company). Phase: Therapeutic confirmatory (Phase III). Countries: Belgium (ended), Denmark (ended), Austria (ended), Netherlands (ended), Germany (ended), France (ended), Ireland (ended), Portugal (ended), Greece (ended), Poland (ended), Hungary (ended), Spain (ended), Czechia (ended), Italy (ended).
Therapeutic area(s): Diseases [C] - Hemic and Lymphatic Diseases [C15]
Gender: Female, Male. Age: 18-64 years, 65+ years. Enrolment: 157.
Status: Ended. Start date (EU): 2021-10-13. End date (EU): 2025-05-23. Decision date: 2024-11-11. Results received: Yes. Last updated: 2025-02-28.
Decision dates by country: BE: 2024-11-13, CZ: 2024-11-12, DK: 2024-11-15, FR: 2024-12-23, DE: 2024-11-13, GR: 2025-01-23, HU: 2024-11-12, IE: 2024-11-11, IT: 2024-12-09, PT: 2024-11-11, ES: 2024-11-11, NL: 2024-11-11, PL: 2024-11-14, AT: 2024-11-18

Condition(s): Light Chain (AL) Amyloidosis
Product: BORTEZOMIB, Birtamimab, SODIUM CHLORIDE

Primary endpoint: Time to all-cause mortality during the Double-blind Phase
Endpoint(s): Change from baseline to Month 9 of the Double-blind Phase in the 6MWT distance (meters), Change from baseline to Month 9 of the Double-blind Phase in the Physical Component Summary (PCS) score of the SF-36v2

Source: https://euclinicaltrials.eu/ctis-public/view/2024-511066-36-00